EU clinical trial 2024-518368-10-00: Phase I/II ex vivo gene therapy clinical trial for RDEB using autologous skin equivalent grafts genetically corrected with a COL7A1-encoding SIN retroviral vector
Protocol code: C12-48
Sponsor: Institut National De La Sante Et De La Recherche Medicale (Laboratory/Research/Testing facility). Phase: Phase I and Phase II (Integrated)- First administration to humans. Countries: France (authorised, recruiting).
Therapeutic area(s): Diseases [C] - Skin and Connective Tissue Diseases [C17]
Gender: Female, Male. Age: 18-64 years, 65+ years. Enrolment: 3.
Status: Authorised, recruiting. Start date (EU): 2025-01-29. Decision date: 2025-01-29. Results received: No. Last updated: 2025-01-29.

Condition(s): Recessive dystrophic epidermolysis bullosa (RDEB)
Product: Skin equivalent graft genetically corrected with a COL7A1-encoding SIN retroviral vector

Primary endpoint: Adverse events (AEs), Serious Adverse Events (SAEs), Adverse Reactions (ARs) and Serious Adverse Reactions (SARs) at each visit over a 12-months period after grafting and at each visit during a long term follow-up period of 5 years in total.
Endpoint(s): Skin biopsy analysis of grafted skin at, M3, M6, M12, M24, M36, M48 and M60 after grafting compared to baseline for: a)C7 protein expression by immunofluorescence microscopy (IF) b)Morphology of anchoring fibrils (Wetzels et al.) at the dermal-epidermal junction (DEJ) by transmission electron microscopy (TEM), Serum analysis at M1, M6, M12, M18, M24, M30, M36, M42, M48, M54 and M60 after grafting compared to baseline for: a)Detection of anti-C7 antibodies by enzyme-linked immunosorbent assay (ELISA) (against the entire C7 molecule) indirect immunofluorescence (IIF) and/or Western blot (WB) b)Detection of T-cell responses to the full length C7 by enzyme-linked immunosorbent spot (ELISPOT) assay, Clinical assessment at M1, M2, M3, M6, M12, M18, M24, M30, M36, M42, M48, M54 and M60 after grafting compared to baseline for: a)The scar quality measured by the Vancouver Scar Scale (VSS) b)Changes in blister numbers over the grafted skin c)Changes in the clinical appearance of grafted skin through clinical photographs at each visit d)Changes in pruritus measured by the Leuven Itch Scale (LIS) e)Changes in Quality of Life Score measured by the QOLEB

Source: https://euclinicaltrials.eu/ctis-public/view/2024-518368-10-00